EU clinical trial 2022-502082-22-00: Semaglutide for the treatment of glucose intolerance in women with prior gestational diabetes: a double blind RCT
Protocol code: S66967
Sponsor: UZ Leuven (Hospital/Clinic/Other health care facility). Phase: Phase III and phase IV (Integrated). Countries: Belgium (ongoing, recruiting).
Therapeutic area(s): Diseases [C] - Nutritional and Metabolic Diseases [C18]
Gender: Female. Age: 18-64 years. Enrolment: 252.
Status: Ongoing, recruiting. Start date (EU): 2023-09-14. Decision date: 2023-05-22. Results received: No. Last updated: 2025-11-19.

Condition(s): prediabetes
Product: placebo for injection in pre-filled pen, Ozempic 1 mg solution for injection in pre-filled pen

Primary endpoint: The development of type 2 diabetes (T2DM) by 160 weeks defined by fasting glycaemia, OGTT and/or HbA1c according to the ADA criteria1
Endpoint(s): Secondary outcomes by 160 weeks (end of treatment) and by 172-184 weeks (3-6 months after stop medication): such as need for rescue therapy for diabetes, prediabe, regression to normoglycaemia, mean BMI, waist circumference, waist/hip circumference, weight loss ≥5%, ≥10% and ≥15%, body fat percentage measured by bioelectrical impedance analysis and Beta-cell function

Source: https://euclinicaltrials.eu/ctis-public/view/2022-502082-22-00